EU clinical trial 2023-508626-10-00: ANRS0392s ELDORADO : Phase III, open-label, randomized, multicenter trial EvaLuating the non-inferiority of DORAvirine versus DOlutegravir based antiretroviral regimens in treatment-naïve people living with HIV-1 infection
Protocol code: ANRS0392s ELDORADO
Sponsor: Inserm (Laboratory/Research/Testing facility). Phase: Therapeutic confirmatory (Phase III). Countries: France (ongoing, recruiting).
Therapeutic area(s): Diseases [C] - Immune System Diseases [C20]; Diseases [C] - Virus Diseases [C02]
Gender: Female, Male. Age: 18-64 years, 65+ years. Enrolment: 60.
Status: Ongoing, recruiting. Start date (EU): 2025-01-08. Decision date: 2024-08-19. Results received: No. Last updated: 2025-10-15.

Condition(s): HIV-1 infection
Product: Truvada 200 mg/245 mg film-coated tablets, Delstrigo 100 mg/300 mg/245 mg film-coated tablets, Tivicay 50 mg film-coated tablets

Primary endpoint: Proportion of subjects in virologic success defined as achieving HIV-1 RNA <50 copies/mL at week 48 under allocated treatment using the FDA snapshot algorithm (window period of 42-54 weeks); subjects not achieving viral success will be described according to the FDA snapshot recommendation
Endpoint(s): Occurrence of obesity at Week 48 and at Week 96, Proportion of subjects with newly measured HOMA≥2 at Week 48 and Week 96 as compared to baseline, Proportion of subjects with hypertension newly detected at Week 48 and Week 96 compared to baseline., Proportion of subjects in virologic success defined as achieving HIV-1 RNA <50 copies/mL at week 96 under allocated treatment using the FDA snapshot algorithm with a window period of 90 to 102 weeks; subjects not achieving viral success will be described according to the FDA snapshot recommendation, Proportion of confirmed virological failures occurring up to Week 48 and up to Week 96, Frequency of HIV-1 drug resistances in participants with a confirmed virological failure, Proportion of subjects achieving HIV 1 RNA<200 copies/mL under allocated treatment at Week 48 and Week 96, Proportion of subjects achieving HIV 1 RNA<1000 copies/mL under allocated treatment at Week 48 and Week 96, Frequency of RT and integrase mutations at baseline and impact on the virological response at Week 48 and Week 96, Occurrence of combined overweight and obesity at Week 48 and at Week 96, Proportion of subjects with ≥10% absolute weight gain from baseline at Week 48 and Week 96, Change from baseline in absolute weight at Week 48 and at Week 96, Proportion of subjects with diabetes newly detected at Week 48 and Week 96 compared to baseline, Any adverse event of any grade and those graded 3-4 at Week 48 and Week 96, Change from baseline in waist and hip circumferences and waist-to-hip ratio at Week 48 and Week 96, Change from baseline in fasting glycemia and insulin at Week 48 and at Week 96, Change from baseline in fasting serum lipids at Week 48 and at Week 96, Change from baseline in estimated glomerular filtration rate at Week 48 and at Week 96, Change from baseline in cardiovascular parameters (blood pressure profile, electrocardiographic and echocardiographic damages) at Week 48 and Week 96, Change from baseline in mean patient CAP and LSM measurements at Week 48 and Week 96 and occurrence at Week 48 and Week 96 of: a. Liver steatosis, clinically significant liver fibrosis and cirrhosis b. MASLD and MASH, Changes from baseline in Fib-4, VCTE and FAST scores at Week 48 and Week 96 and presence at baseline or occurrence of CSF defined as Fib-4 ≥2.67 or FAST score > 0.67, Change from baseline in EQ-5D-3L, HIVTSQ, DASS-21, PSQI, WHOQOL HIV-BREF scores at Week 24, Week 48 and Week 96, Proportion of subjects with AIDS (defined as having CDC stage 3/C or WHO stage 4), tuberculosis, IRIS or death at Week 48 and Week 96, a, b, c, d. DOR, DTG and M9 trough plasma concentration in samples taken pre-dose at Week 4, Week 24, Week 48 and Week 96, Change from baseline in CD4 cell count, CD4 percentage, CD8 cell count, CD8 percentage, CD4/CD8 ratio, at Week 48 and at Week 96, Adherence to ART by (1) pill count (considering a pill count adherence ratio <95% as sub-optimal adherence), (2) 4-days and 1-month recall questions at every trial visit, (3) by TFV-DP quantification in dried blood spots (LC/MS) at Week 48 and Week 96, a. Type and frequency of alleles variants in the gene coding for CYP3A5/4 b. Impact of CYP3A5/4 mutations on pharmacokinetics of DOR, DTG and M9, c. Virological response and side-effects depending on CYP3A5/4 mutations, Assess additional polymorphism of UGT1A1 at baseline, Cost-effectiveness measured by (1) Incremental health benefits of using one regimen compared to the other (in DALYs and QALYs), (2) Incremental economic costs of using one regimen compared to the other (USD), (3) Budget impact of changing from one regimen to the other (USD), a. Change from baseline in truncal fat distribution at Week 48 and Week 96. b. Change from baseline in adipose tissue markers (adiponectin, leptin) and immune activation markers (sCD14, sCD163) at Week 48 and Week 96. c. Change from baseline (by abdominal subcutaneous surgical biopsy) in fat pathology, gene expression and global transcriptome analysis (RT-PCR and RNAseq) at Week 48

Source: https://euclinicaltrials.eu/ctis-public/view/2023-508626-10-00